EU clinical trial 2023-508840-22-00: A multicenter, single-arm, open label trial to evaluate efficacy and safety of oral, twice daily LNP023 in adult aHUS patients who are naive to complement inhibitor therapy
Protocol code: CLNP023F12301
Sponsor: Novartis Pharma AG (Pharmaceutical company). Phase: Therapeutic confirmatory (Phase III). Countries: Slovenia (ended), Slovakia (ended), Czechia (ended), Greece (ended), Austria (ended).
Therapeutic area(s): Diseases [C] - Hemic and Lymphatic Diseases [C15]
Gender: Female, Male. Age: 18-64 years, 65+ years. Enrolment: 17.
Status: Ended. Start date (EU): 2022-06-27. End date (EU): 2025-09-18. End date: 2026-04-11. Decision date: 2024-07-01. Results received: No. Last updated: 2025-08-22.
Decision dates by country: AT: 2024-07-03, CZ: 2024-08-01, GR: 2024-07-22, SK: 2024-07-03, SI: 2024-07-01

Condition(s): Atypical hemolytic uremic syndrome
Product: IPTACOPAN

Primary endpoint: Complete TMA response without the use of PE/PI and anti-C5 antibody during 26 weeks of study treatment. Complete TMA Response is defined as (1) hematological normalization in platelet count (platelet count ≥150 x 109/L) and LDH (below ULN), and (2) improvement in kidney function (≥ 25% serum creatinine reduction from baseline), maintained for two measurements obtained at least four weeks apart, and any measurement in between.
Endpoint(s): Time to achieve TMA response during 26 weeks of study treatment., Response is defined as an increase in hemoglobin of ≥ 2 g/dL from baseline, observed at two measurements obtained at least 4 weeks apart and any measurement in between during 26 weeks of study treatment., Change from baseline in hematologic parameters (platelets, LDH, hemoglobin) at Week 26., Proportion of participants on dialysis (done for this TMA event) who no longer require dialysis through 26 weeks of study treatment., Change from baseline in eGFR values at Week 26., Change from baseline in CKD stage (1-5) based on eGFR categories at Week 26., Change from baseline in patient-reported outcomes score for FACIT-Fatigue, Patient Global Impression of Severity (PGIS), EuroQol 5-level EQ-5D version (EQ-5D-5L) and Short-form 36 health survey questionnaire version 2 (SF-36 v2) at Week 26., Safety evaluations (including adverse events/serious adverse events (SAE), safety laboratory parameters and vital signs).

Source: https://euclinicaltrials.eu/ctis-public/view/2023-508840-22-00